EU clinical trial 2024-512579-11-00: A Multicentre, Open-Label, Single Ascending Dose, Dose-Ranging, Phase I/IIa Study to Evaluate the Safety and Tolerability of an Autologous Antigen-Specific Chimeric Antigen Receptor T Regulatory Cell Therapy (TX200-TR101) in Living Donor Renal Transplant Recipients
Protocol code: TX200-KT02
Sponsor: Sangamo Therapeutics France (Pharmaceutical company). Phase: Phase I and Phase II (Integrated)- First administration to humans. Countries: Belgium (ended), Netherlands (ended).
Therapeutic area(s): Diseases [C] - Immune System Diseases [C20]
Gender: Female, Male. Age: 18-64 years, 65+ years. Enrolment: 48.
Status: Ended. Start date (EU): 2021-03-17. End date (EU): 2025-10-16. End date: 2025-10-17. Decision date: 2024-06-27. Results received: No. Last updated: 2025-04-14.
Decision dates by country: BE: 2024-06-27, NL: 2024-06-28

Condition(s): Prophylaxis against renal transplant rejection
Product: TX200-TR101

Primary endpoint: Incidence and grade of TEAEs, including SAEs, within 28 days post TX200-TR101 infusion.
Endpoint(s): 1. From the day of TX200-TR101 infusion through to Week 84 - Incidence of BCAR according to the Banff criteria, Time to first BCAR episode, Type and severity of any BCAR episodes according to the Banff criteria., 2. From the day of TX200-TR101 infusion through to Week 84: Incidence and grade of TEAEs, including SAEs. Incidence of opportunistic infections, specifically BKV, EBV and CMV reactivation. Incidence of neoplasia., 3. Proportion of subjects who are receiving tacrolimus monotherapy at Week 84., Cumulative dose of immunosuppression, including but not limited to MPA/MMF and tacrolimus through to Week 84., 4. Presence of CD4 positive cells that are also positive for HLA-A2 CAR RNA transcripts in the renal transplant biopsy at Week 16 (4 weeks following TX200-TR101 infusion)., 5. From the day of TX200-TR101 infusion through to Week 84. Incidence and severity of chronic graft dysfunction, as measured by eGFR. Incidence and severity of chronic graft dysfunction, as measured by the Banff criteria for chronic rejection including the Banff lesion score i-IFTA. Incidence of graft loss due to rejection. Incidence and (semi-quantitative) intensity of de novo DSA.

Source: https://euclinicaltrials.eu/ctis-public/view/2024-512579-11-00